EU clinical trial 2024-512360-55-00: A randomized phase II study to evaluate the safety and efficacy of trastuzumab deruxtecan versus CDK4/6 inhibitor-based endocrine therapy as first-line therapy of HR-positive and HER2-low/ultra-low advanced breast cancer patients classified as non-luminal subtype according to gene expression profiling (The PONTIAC Study).
Protocol code: MEDOPP556
Sponsor: Medica Scientia Innovation Research S.L. (Pharmaceutical company). Phase: Therapeutic exploratory (Phase II). Countries: Portugal (ongoing, recruiting), Belgium (ongoing, recruiting), Netherlands (authorised, recruiting), Spain (ongoing, recruiting), Italy (ongoing, recruiting), France (ongoing, recruiting), Germany (authorised, recruiting), Poland (authorised, recruiting), Austria (authorised, recruiting).
Therapeutic area(s): Diseases [C] - Neoplasms [C04]
Gender: Female, Male. Age: 18-64 years, 65+ years. Enrolment: 194.
Start date (EU): 2025-06-30. Decision date: 2025-06-09. Results received: No. Last updated: 2026-06-16.
Decision dates by country: BE: 2025-06-11, NL: 2025-06-11, PL: 2025-06-10, FR: 2025-09-30, DE: 2025-06-16, AT: 2025-06-11, PT: 2025-06-11, IT: 2025-06-11, ES: 2025-06-09

Condition(s): Unresectable locally recurrent or metastatic hormone receptor (HR)-positive and human epidermal growth factor receptor 2 (HER2)-low/ultralow breast cancer classified as non-luminal by gene expression profiling.
Product: Exemestano Teva 25 mg comprimidos recubiertos con película EFG, Letrozol Tevagen 2,5 mg comprimidos recubiertos con película EFG, Verzenios 100 mg film-coated tablets, IBRANCE 125 mg film-coated tablets, DS-8201a, GOSERELIN, LEUPRORELIN, Kisqali 200 mg film-coated tablets, Anastrozol Teva 1 mg comprimidos recubiertos con película EFG, IBRANCE 75 mg film-coated tablets, Fulvestrant Teva 250 mg solución inyectable en jeringa precargada EFG, Verzenios 50 mg film-coated tablets, Verzenios 150 mg film-coated tablets, IBRANCE 100 mg film-coated tablets

Primary endpoint: PFS, defined as the period from randomization date to the first occurrence of documented radiographic disease progression or death from any cause, whichever occurs first, as determined locally by the investigator using RECIST v.1.1. in HER2-low patients., PFS, defined as the period from randomization date to the first occurrence of documented radiographic disease progression or death from any cause, whichever occurs first, as determined locally by the investigator using RECIST v.1.1 in all patients.
Endpoint(s): OS, defined as the period from randomization date to death from any cause, as determined locally by the investigator (in all patients and HER2-low population)., ORR, defined as the rate of patients with complete response (CR) or partial response (PR), as determined locally by the investigator using RECIST v.1.1 (in all patients and HER2-low population)., CBR, defined as the rate of patients with objective response (CR or PR), or stable disease for at least 24 weeks, as determined locally by the investigator using RECIST v.1.1 (in all patients and HER2-low population)., DoR, defined as the period from the first occurrence of a documented objective response to disease progression or death from any cause, whichever occurs first, as determined locally by the investigator using RECIST v.1.1 (in all patients and HER2-low population)., TTR, defined as the period from randomization date to the first objective tumor response (tumor shrinkage of ≥ 30%) observed for patients who achieved a CR or PR, as determined locally by the investigator using RECIST v.1.1 (in all patients and HER2-low population)., TTF, defined as the time from randomization date to discontinuation of treatment for any reason, including progressive disease, treatment toxicity, patient choice, and death., TFSC: time to first subsequent chemotherapy, defined as the time from randomization date to the beginning of the first subsequent chemotherapy after discontinuation of the trial regimen, Best percentage of change from baseline in the size of target tumor lesions, defined as the biggest decrease, or smallest increase if no decrease will be observed, as determined locally by the investigator using RECIST v.1.1., PFS2 is defined as the time from randomization date to the earliest progression event after that used for the primary variable PFS, or date of death as determined locally by the investigator using RECIST v.1.1., TFST, defined as the time from randomization to the earliest date of anti-cancer therapy start date following Study treatment discontinuation, or death., Changes from baseline in the EORTC QLQ-C30, EORTC QLQ-BR42 scales and the EQ-5D-5L index., Time to deteriorate in the EORTC QLQ-C30 and QLQ-BR42 subscales., Safety endpoints: Safety and tolerability as per NCI-CTCAE v.5.0., Exploratory endpoints can include (but are not limited to): Association of clinical outcomes, safety and/or tolerability profile with mutation profiling, copy number variability, gene expression, multiplex assays, proteomic analyses, digital pathology, immunohistochemistry, taxonomic or functional analyses performed on tissue and/or liquid biopsy samples., Exploratory endpoints can include (but are not limited to): Efficacy endpoints for all patients according to different clinicopathological characteristics and prior treatment for early breast cancer., Exploratory endpoints can include (but are not limited to): Association of treatment efficacy and/or safety outcomes in all patients with radiological imaging biomarkers.

Source: https://euclinicaltrials.eu/ctis-public/view/2024-512360-55-00